EU clinical trial 2023-506413-22-00: A Phase III, Randomized, Double-Blind, Placebo Controlled, Multi-Center, International Study of Durvalumab Given Concurrently With Definitive Chemoradiation Therapy in Patients With Locally Advanced, Unresectable Esophageal Squamous Cell Carcinoma (KUNLUN).
Protocol code: D910SC00001/KUNLUN
Sponsor: Astrazeneca AB (Pharmaceutical company). Phase: Therapeutic confirmatory (Phase III). Countries: Spain (ongoing, recruitment ended), France (ongoing, recruitment ended), Belgium (ongoing, recruitment ended), Poland (ongoing, recruitment ended).
Therapeutic area(s): Diseases [C] - Neoplasms [C04]
Gender: Female, Male. Age: 18-64 years, 65+ years. Enrolment: 48.
Status: Ongoing, recruitment ended. Start date (EU): 2021-03-31. Decision date: 2024-04-08. Results received: No. Last updated: 2026-05-12.
Decision dates by country: ES: 2024-04-08, PL: 2024-04-16, FR: 2024-04-08, BE: 2024-04-22

Condition(s): Locally Advanced Unresectable Esophageal Squamous Cell Carcinoma
Product: Cisplatin 1 mg/ml Concentrate for Solution for Infusion, Capecitabine Accord 500 mg film-coated tablets, Inflectra 100 mg powder for concentrate for solution for infusion, IMFINZI 50 mg/mL concentrate for solution for infusion., The Placebo is formulated as 26 mM histidine/histidine-HCl, 275 mM trehalose dihydrate, 0.02% (w/v) polysorbate 80, pH 6.0., Fluorouracil Injection, 50 mg/ml, solution for injection, Mycophenolate Mofetil Accord 250 mg capsules, Capecitabine Accord 150 mg film-coated tablets

Primary endpoint: PFS using BICR assessments according to RECIST 1.1 in patients with PD-L1 TAP≥1% tumors
Endpoint(s): PFS using BICR assessments according to RECIST 1.1 in all randomized patients OS, OS36, PFS2 APF24,ORR, DoR, DCR and TTP per RECIST 1.1 as assessed by BICR in all randomized patients and in patients with PD-L1 TAP≥1% tumors Time to deterioration and change from baseline in symptoms, functioning, and HRQoL as measured by EORTC QLQ-C30 and QLQ-OES18 Concentration of durvalumab in blood ADA in all randomized patients

Source: https://euclinicaltrials.eu/ctis-public/view/2023-506413-22-00